EU clinical trial 2023-503895-25-00: Preventing caRdiovascular collapsE with VasoprEssors duriNg Tracheal IntubatiON: The PREVENTION Randomized Controlled Trial
Protocol code: IRFMN-9063
Sponsor: Universita Degli Studi Di Torino (Educational Institution). Phase: Therapeutic confirmatory (Phase III). Countries: Italy (ongoing, recruiting), Ireland (ongoing, recruiting).
Therapeutic area(s): Diseases [C] - Cardiovascular Diseases [C14]
Gender: Female, Male. Age: 18-64 years, 65+ years. Enrolment: 560.
Status: Ongoing, recruiting. Start date (EU): 2024-08-01. Decision date: 2024-03-06. Results received: No. Last updated: 2026-06-12.
Decision dates by country: IT: 2024-03-06, IE: 2025-03-07

Condition(s): criticall illness
Product: NORADRENALINA TARTRATO MONICO 2 mg/ml Concentrato per soluzione per infusione

Primary endpoint: Mean arterial pressure (MAP) < 60 mmHg, Cardiac arrest
Endpoint(s): Incidence of cardiac arrest, Rate of mean arterial pressure (MAP) < 60 mmHg, Lowest systolic blood pressure within 30 minutes from induction, Rate of need for a rescue vasopressor, Change in systolic blood pressure from last value before induction to lowest value up to 30 minutes from induction, Incidence of severe hypertension (MAP > 120 mmHg) by 30 minutes from induction

Source: https://euclinicaltrials.eu/ctis-public/view/2023-503895-25-00